EU clinical trial 2023-505789-27-00: A Modular Phase II, Single-arm, Multicenter, Open-label Study to Evaluate the Efficacy and Safety of Surovatamig (AZD0486) in Participants with Relapsed or Refractory B-cell Non-Hodgkin Lymphoma (SOUNDTRACK-B) )
Sponsor: Astrazeneca AB (Pharmaceutical company). Phase: Therapeutic exploratory (Phase II). Countries: Germany (ongoing, recruiting), Spain (ongoing, recruiting), Denmark (ongoing, recruiting), Italy (ongoing, recruiting), Sweden (ongoing, recruiting), France (ongoing, recruiting).
Therapeutic area(s): Diseases [C] - Hemic and Lymphatic Diseases [C15]
Gender: Female, Male. Age: 18-64 years, 65+ years. Enrolment: 82.
Status: Ongoing, recruiting. Start date (EU): 2025-04-14. Decision date: 2025-02-17. Results received: No. Last updated: 2026-06-01.
Decision dates by country: IT: 2025-02-18, DK: 2025-02-19, DE: 2025-02-19, ES: 2025-02-18, FR: 2025-02-17, SE: 2025-02-20

Condition(s): Relapsed or Refractory Non-Hodgkin Lymphoma
Product: AZD0486, AZD0486

Primary endpoint: ORR, defined as the proportion of participants achieving either a PR or CR based on Lugano 2014 Response Criteria as determined by an IRC
Endpoint(s): 1. Safety and tolerability of surovatamig - incidence, nature, and severity of AEs/SAEs/AESI, changes in laboratory data, vital signs, and ECGs compared with baseline, incidence and nature of study drug discontinuation, dose reduction, and dose delay due to AEs, 2. Efficacy - DoR and CR, ORR and CR rates, 3. Efficacy - DoCR, TTR, EFS, PFS, TTNT, OS, 4. PK - PK parameters such as such as Cmax, Tmax, Ctrough of surovatamig (at predefined intervals), 5. Immunogenicity -pre-existing and induced ADA for surovatamig, 6. PROs - difference in severity levels in fatigue, pain, cognition and overall side-effect burden, 7. MRD-negative CR rate

Source: https://euclinicaltrials.eu/ctis-public/view/2023-505789-27-00